EU clinical trial 2024-517931-29-00: LIBERATE; From Inflammation Biomarkers to Remodelling (FAPI PET/CT) towards personalized diagnosis in post-acute sequelae of COVID-19
Protocol code: 19097
Sponsor: Universitair Medisch Centrum Groningen (Hospital/Clinic/Other health care facility). Phase: Phase III and phase IV (Integrated). Countries: Netherlands (authorised, recruiting).
Therapeutic area(s): Analytical, Diagnostic and Therapeutic Techniques and Equipment [E] - Diagnosis [E01]; Diseases [C] - Respiratory Tract Diseases [C08]
Gender: Female, Male. Age: 18-64 years, 65+ years. Enrolment: 60.
Status: Authorised, recruiting. Start date (EU): 2025-07-01. Decision date: 2025-01-20. Results received: No. Last updated: 2025-09-22.

Condition(s): post-acute sequelae of COVID-19
Product: [68Ga]FAPI-46

Primary endpoint: TBRLung (Target to background ratio of the lung) differences per group
Endpoint(s): SUVmean and SUVmax of both paravertebral muscles, [68Ga]FAPI uptake (SUVmean) vs % of ground galss opacities (GGO) on high resolution CT, [68Ga]FAPI uptake (SUVmean) related to the outcome of multiple questionnaires., [68Ga]FAPI uptake (SUVmean) related to patience health metrics (lung function and 6-MWT), [68Ga]FAPI uptake (SUVmean) related to biology (circulating extra cellular matrix fragments, circulating soluble FAP, inflammatory blood markers and systemic and upper respiratory tract cellular phenotypes)

Source: https://euclinicaltrials.eu/ctis-public/view/2024-517931-29-00